EU clinical trial 2024-513672-17-00: IMPACT-CTEPH Initial dual oral coMbination therapy versus standard-of-care initial oral monotherapy Prior to balloon pulmonary Angioplasty in patients with inoperable Chronic thromboembolic pulmonary hyperTension”
Protocol code: APHP201037
Sponsor: Assistance Publique Hopitaux De Paris (Hospital/Clinic/Other health care facility). Phase: Therapeutic exploratory (Phase II). Countries: France (ended).
Therapeutic area(s): Diseases [C] - Respiratory Tract Diseases [C08]
Gender: Female, Male. Age: 18-64 years, 65+ years. Enrolment: 96.
Status: Ended. Start date (EU): 2021-06-14. End date (EU): 2025-07-03. Decision date: 2024-11-05. Results received: No. Last updated: 2024-11-05.

Condition(s): Inoperable Chronic thromboembolic pulmonary hyperTension, Pneumology
Product: Placebo de macitentan 10 mg, MACITENTAN

Primary endpoint: Pulmonary vascular resistance (PVR) at rest at week 16 expressed as a percentage of the baseline resting PVR.
Endpoint(s): Change from baseline to week 16 in : - 6-min walk distance (6MWD) - World Health Organisation (WHO) functional class (FC) and Borg dyspnea score - N-terminal pro-brain natriuretic peptide (NT-proBNP) level - Quality of life EQ-5D-3L scale., Change from baseline to week 42 in : - 6MWD - WHO FC and Borg dyspnea score - NT proBNP level - Quality of life EQ-5D-3L scale., Change from baseline to week 42 in PVR., Percentage of subjects reaching PVR<240 dyn.sec.cm-5 at week 42., Frequency and type of BPA procedure-related complications from BPA procedure to end-of-study., Time from randomization to the first PH-related disease progression event up to end-of-study, defined as any of the following : - Death (all causes) - Need for lung transplantation - Hospitalization due to PH - Initiation of parenteral prostanoid therapy due to PH-related disease progression - Clinical worsening defined as a post-baseline decrease in 6MWD by ≥ 15 % combined with WHO FC III or IV)., Change from baseline to week 29 in : - 6MWD - WHO FC and Borg dyspnea score - NT proBNP level - Quality of life EQ-5D-3L scale.

Source: https://euclinicaltrials.eu/ctis-public/view/2024-513672-17-00